EU clinical trial 2024-513578-23-00: A Phase 2 Master Protocol to assess the efficacy and safety of FORE8394, an inhibitor of BRAF Class 1 and Class 2 alterations, in participants with cancer harboring BRAF alterations
Protocol code: F8394-201
Sponsor: Fore Biotherapeutics Inc. (Pharmaceutical company). Phase: Therapeutic exploratory (Phase II). Countries: Spain (ongoing, recruiting), Italy (ongoing, recruiting), France (ongoing, recruiting), Germany (ongoing, recruiting), Sweden (ongoing, recruiting), Norway (ongoing, recruiting), Netherlands (ongoing, recruiting).
Therapeutic area(s): Diseases [C] - Neoplasms [C04]
Gender: Female, Male. Age: 0-17 years, 18-64 years, 65+ years. Enrolment: 134.
Status: Ongoing, recruiting. Start date (EU): 2023-03-21. Decision date: 2024-08-22. Results received: No. Last updated: 2026-07-20.
Decision dates by country: IT: 2024-09-17, DE: 2024-08-30, SE: 2024-08-23, NO: 2025-05-14, FR: 2024-09-03, NL: 2026-04-24, ES: 2024-08-22

Condition(s): Tumors harboring BRAF alterations
Product: Tybost 150 mg film-coated tablets, Tybost 150 mg film-coated tablets, Tybost 150 mg film-coated tablets, Tybost 150 mg film-coated tablets, COBICISTAT, Tybost 150 mg film-coated tablets

Primary endpoint: 1. Objective Response Rate (ORR) (Subprotocol A, B and C): ORR will be determined by standard tumor response criteria by blinded independent central review (BICR), 2. Pharmacokinetics (Subprotocol D): Systemic exposure of plixorafenib measured by Cmax and AUC.

Source: https://euclinicaltrials.eu/ctis-public/view/2024-513578-23-00